EU clinical trial 2026-526113-28-00: Prospective, multicenter, randomized study on combined LT4 + LT3 therapy versus LT4 in the control of TSH in patients with advanced thyroid cancer treated with tyrosine kinase inhibitors.
Sponsor: Ceinge Biotecnologie Avanzate Franco Salvatore S.c.a.r.l. (Laboratory/Research/Testing facility). Phase: Therapeutic use (Phase IV). Countries: Italy (authorised, recruitment pending).
Therapeutic area(s): Diseases [C] - Hormonal diseases [C19]; Diseases [C] - Neoplasms [C04]
Gender: Female, Male. Age: 18-64 years, 65+ years. Enrolment: 110.
Status: Authorised, recruitment pending. Decision date: 2026-06-26. Results received: No. Last updated: 2026-07-06.

Condition(s): Advanced thyroid carcinoma. Post-thyroidectomy hypothyroidism.
Product: Liotir 5 microgrammi/ml soluzione orale, EUTIROX 100 microgrammi compresse, Liotir 10 microgrammi/ml soluzione orale, Liotir 15 microgrammi/ml soluzione orale, LEVOTIRSOL 100 microgrammi soluzione orale in contenitore monodose, Liotir 20 microgrammi/ml gocce orali, soluzione, Liotir 20 microgrammi/ml soluzione orale

Primary endpoint: Number and proportion of patients in each group who maintain TSH within the target range (0.1–4 mIU/L) throughout the study without any dose adjustments of LT4 and/or LT3.
Endpoint(s): Absolute change from baseline in serum FT3 and FT4 concentrations (ΔFT3, ΔFT4) at weeks 4, 12, and 24 after TKI initiation., Absolute change from baseline in EORTC QLQ–C30 v3.0 questionnaire scores at weeks 4, 12, and 24 after TKI initiation., Change from baseline in LDL cholesterol at weeks 4, 12, and 24 after TKI initiation., Association between changes in serum thyroid hormone levels and the Thr92Ala polymorphism of the DIO2 gene., Treatment safety, with reference to the duration of excessive TSH suppression (TSH <0.1 mIU/L) and time spent outside the target range (TSH >4 mIU/L)., Time to first TSH deviation above the target range (TSH >4 mIU/L) after the initiation of TKI., Percentage of time serum TSH values remain within the target range (0.1–4 mIU/L) after the initiation of TKI.

Source: https://euclinicaltrials.eu/ctis-public/view/2026-526113-28-00